EU clinical trial 2025-521642-14-00: An Open-Label Extension, Multi-centered, Phase 2 Trial to Describe the Safety and Efficacy of TEV-56286 (Emrusolmin) in Participants with Multiple System Atrophy
Protocol code: TV56286-NDG-20041
Sponsor: Teva Branded Pharmaceutical Products R&D LLC (Pharmaceutical company). Phase: Therapeutic exploratory (Phase II). Countries: France (ongoing, recruiting), Germany (ongoing, recruiting), Italy (ongoing, recruiting), Spain (ongoing, recruiting).
Therapeutic area(s): Diseases [C] - Nervous System Diseases [C10]
Gender: Female, Male. Age: 18-64 years, 65+ years. Enrolment: 149.
Status: Ongoing, recruiting. Start date (EU): 2026-03-05. Decision date: 2026-02-04. Results received: No. Last updated: 2026-07-10.
Decision dates by country: DE: 2026-02-04, ES: 2026-02-12, IT: 2026-02-06, FR: 2026-02-16

Condition(s): Multiple System Atrophy
Product: Emrusolmin

Primary endpoint: The primary safety and tolerability endpoints are as follows: • number (%) of participants experiencing an adverse event, The primary safety and tolerability endpoints are as follows: • number (%) of participants who withdraw from the trial due to an adverse event

Source: https://euclinicaltrials.eu/ctis-public/view/2025-521642-14-00